EU clinical trial 2023-509053-32-00: A Phase III, Randomized, Double-blind, Placebo-controlled, Multicenter Study of Transarterial Chemoembolization (TACE) in Combination with either Durvalumab Monotherapy or Durvalumab plus Bevacizumab Therapy in Patients with Locoregional Hepatocellular Carcinoma (EMERALD-1)
Protocol code: EMERALD-1
Sponsor: AstraZeneca AB (Pharmaceutical company). Phase: Therapeutic confirmatory (Phase III). Countries: Italy (ended), France (ended), Spain (ended).
Therapeutic area(s): Diseases [C] - Neoplasms [C04]
Gender: Female, Male. Age: 18-64 years, 65+ years. Enrolment: 76.
Status: Ended. Start date (EU): 2019-07-17. End date (EU): 2026-03-23. Decision date: 2024-02-16. Results received: No. Last updated: 2025-10-14.
Decision dates by country: IT: 2024-03-11, FR: 2024-02-21, ES: 2024-06-13

Condition(s): Locoregional Hepatocellular Carcinoma (HCC)
Product: INFLIXIMAB, MYCOPHENOLATE MOFETIL, Placebo, BEVACIZUMAB, IMFINZI 50 mg/mL concentrate for solution for infusion., BEVACIZUMAB

Primary endpoint: Progression Free Survival (PFS) per RECIST 1.1 as assessed by BICR
Endpoint(s): Overall Survival (OS). Objective Response Rate (ORR). Disease Control Rate (DCR). Duration of Response (DoR). Time to progression (TTP). Time from Randomization to Second Progression PFS (PFS2). Health-related quality of life (HRQoL) patient reported outcomes.

Source: https://euclinicaltrials.eu/ctis-public/view/2023-509053-32-00